EU clinical trial 2024-516634-35-00: Treatment of Established Status Epilepticus in the Elderly - a prospective, randomized, double-blind comparative effectiveness trial
Protocol code: ToSEE
Sponsor: Universitaet Leipzig (Educational Institution). Phase: Therapeutic use (Phase IV). Countries: Germany (ongoing, recruiting).
Therapeutic area(s): Diseases [C] - Nervous System Diseases [C10]
Gender: Female, Male. Age: 65+ years. Enrolment: 132.
Status: Ongoing, recruiting. Start date (EU): 2024-02-01. Decision date: 2024-10-11. Results received: No. Last updated: 2025-08-07.

Condition(s): Convulsive or nonconvulsive benzodiazepine-resistant (established) status epilepticus (eSE) in people 65 years or older
Product: VALPROIC ACID, LEVETIRACETAM

Primary endpoint: Primary endpoint is the effectiveness of intravenous valproate (VPA) or levetiracetam (LEV) to terminate eSE and maintain control of epileptic activity up to 60 minutes after initiation of the trial intervention

Source: https://euclinicaltrials.eu/ctis-public/view/2024-516634-35-00